EU clinical trial 2026-527164-32-00: Bioequivalence clinical trial of two formulations of dapagliflozin/metformin
Protocol code: UECHUPALTDAPMET/26-2
Sponsor: Laboratorios Alter S.A. (Pharmaceutical company). Phase: Human Pharmacology (Phase I)- Bioequivalence Study. Countries: Spain (authorised, recruitment pending).
Therapeutic area(s): Diseases [C] - Nutritional and Metabolic Diseases [C18]
Gender: Female, Male. Age: 18-64 years. Enrolment: 36.
Status: Authorised, recruitment pending. Decision date: 2026-07-17. Results received: No. Last updated: 2026-07-17.

Condition(s): Healthy participants

Source: https://euclinicaltrials.eu/ctis-public/view/2026-527164-32-00